EU clinical trial 2023-509238-20-00: A Phase 1 Single Center Clinical Trial Evaluating Safety of 5-Aminolevulinic Acid (5-ALA) Combined With CV01 Delivery of Ultrasound for Sonodynamic Therapy (SDT) in Patients With Newly Diagnosed High-Grade Glioma (HGG) Prior to Resection and Standard Adjuvant Therapy
Protocol code: WWU22_0032
Sponsor: Universitaet Muenster (Educational Institution). Phase: Therapeutic exploratory (Phase II). Countries: Germany (ended).
Therapeutic area(s): Diseases [C] - Neoplasms [C04]
Gender: Female, Male. Age: 18-64 years, 65+ years. Enrolment: 14.
Status: Ended. Start date (EU): 2025-11-21. End date (EU): 2026-02-09. Decision date: 2024-11-05. Results received: No. Last updated: 2025-11-25.

Condition(s): High grade glioma
Product: Gliolan 30 mg/ml powder for oral solution., Gliolan 30 mg/ml powder for oral solution., Gliolan 30 mg/ml powder for oral solution.

Primary endpoint: Clinical safety and tolerability will be assessed based on the observation of adverse events (AEs). AEs will be graded as per the NCI CTCAE v5. Patients will be assessed for AEs for 28 days following administration of SDT (marking study completion). Pathological findings of laboratory evaluations (specifically, complete blood counts and serum chemistries [including liver function tests] and physical examinations [including a detailed neurological examination]) will be documented as AEs.
Endpoint(s): Radiological changes: Changes on MRI between visit 1 (pre SDT) and visit 3 (post SDT) of tumor volume (enhancing tumor including necrosis, cm³), volume of FLAIR hyperintensity (cm³), volume of cytotoxic edema based on diffusion restriction on corresponding ADC and DWI sequences (cm³), relative cerebral blood volume (rCBVmax) and leakage (K2, 0.001/min)., Histopathological efficacy: Anti-tumor activity assessed by number of cells / mm³ with antibodies against IBA1 and number of cells / mm³ with antibodies against Caspase III

Source: https://euclinicaltrials.eu/ctis-public/view/2023-509238-20-00